EU clinical trial 2023-504400-29-00: A Phase 1a/1b Study Exploring the Safety and Tolerability of INCB081776 in Participants With Advanced Malignancies
Protocol code: INCB 81776-101
Sponsor: Incyte Corp. (Pharmaceutical company). Phase: Human Pharmacology (Phase I)- First administration to humans. Countries: Netherlands (ended).
Therapeutic area(s): Diseases [C] - Neoplasms [C04]
Gender: Female, Male. Age: 18-64 years, 65+ years. Enrolment: 9.
Status: Ended. Start date (EU): 2022-09-15. End date (EU): 2025-09-10. End date: 2025-09-10. Decision date: 2024-08-30. Results received: No. Last updated: 2025-04-23.

Condition(s): Advanced malignancies.

Source: https://euclinicaltrials.eu/ctis-public/view/2023-504400-29-00